EU clinical trial 2025-520467-40-00: Phase 1/2 Study of Intravesical MK-3120 in BCG-Naïve or BCG-Exposed High-Risk Non-muscle Invasive Bladder Cancer
Protocol code: MK-3120-003
Sponsor: Merck Sharp & Dohme LLC (Pharmaceutical company). Phase: Phase I and Phase II (Integrated)- Other. Countries: Belgium (authorised, recruiting), Greece (ongoing, recruiting), Austria (authorised, recruiting), Spain (authorised, recruiting), Norway (authorised, recruiting), Netherlands (ongoing, recruiting), Italy (authorised, recruiting), France (authorised, recruiting).
Therapeutic area(s): Diseases [C] - Neoplasms [C04]
Gender: Female, Male. Age: 18-64 years, 65+ years. Enrolment: 32.
Start date (EU): 2026-03-16. Decision date: 2025-12-22. Results received: No. Last updated: 2026-03-20.
Decision dates by country: NL: 2025-12-30, GR: 2025-12-22, ES: 2026-01-09, IT: 2025-12-22, NO: 2026-01-07, AT: 2025-12-22, FR: 2025-12-23, BE: 2026-01-09

Condition(s): High-risk non-muscle invasive bladder cancer (NMIBC) with carcinoma in situ (CIS) with or without papillary tumors
Product: MK-3120

Primary endpoint: Number of Participants Who Experience a Dose-limiting Toxicity (DLT), Number of Participants Who Experience One or More Adverse Events (AEs), Number of Participants Who Discontinue Study Treatment Due to AEs
Endpoint(s): Complete Response Rate (CRR)

Source: https://euclinicaltrials.eu/ctis-public/view/2025-520467-40-00